EU clinical trial 2022-500398-15-00: A PHASE 1, RANDOMIZED, DOUBLE-BLIND, PLACEBO-CONTROLLED SINGLE CENTER STUDY TO EVALUATE THE SAFETY, TOLERABILITY, PHARMACOKINETICS, AND PHARMACODYNAMICS OF SINGLE ASCENDING DOSES OF REGN7999, A TMPRSS6 ANTAGONIST, IN HEALTHY ADULT SUBJECTS
Protocol code: R7999-HV-2154
Sponsor: Regeneron Pharmaceuticals Inc. (Pharmaceutical company). Phase: Human Pharmacology (Phase I)- First administration to humans. Countries: Belgium (ended).
Therapeutic area(s): Diseases [C] - Hemic and Lymphatic Diseases [C15]
Gender: Female, Male. Age: 18-64 years. Enrolment: 64.
Status: Ended. Start date (EU): 2022-10-24. End date (EU): 2023-08-24. End date: 2023-08-24. Decision date: 2022-10-03. Results received: Yes. Last updated: 2022-12-13.

Condition(s): Healthy - R7999 being developed for the treatment of diseases associated with iron overload.
Product: REGN7999, REGN7999

Primary endpoint: Incidence and severity of treatment emergent adverse events (TEAEs) in participants treated with REGN7999 or placebo through the end of study visit (week 20 for IV cohorts 1 to 4 and for SC cohorts 1 and 2, and week 26 for IV cohort 5 and SC cohort 3)
Endpoint(s): Concentrations of REGN7999 in serum through the end of study visit (week 20 for IV cohorts 1 to 4 and for SC cohorts 1 and 2 and week 26 for IV cohort 5 and SC cohort 3), Incidences of anti-drug antibodies (ADA) to REGN7999 over time through the end of study visit (week 20 for IV Cohorts 1 to 4 and SC Cohort 1 and 2 and week 26 for IV Cohort 5 and SC cohort 3).

Source: https://euclinicaltrials.eu/ctis-public/view/2022-500398-15-00